EU clinical trial 2025-522001-38-00: A Phase 2, Multi-Center, Platform Study to Evaluate the Safety, Efficacy, Pharmacokinetics, and Pharmacodynamics with Multiple Therapies in Participants with Active Crohn’s Disease or Active Ulcerative Colitis (ASCEND-IBD)
Protocol code: MT-100-201
Sponsor: Mirador Therapeutics Inc. (Pharmaceutical company). Phase: Therapeutic exploratory (Phase II). Countries: Poland (ongoing, recruiting), Bulgaria (authorised, recruitment pending), Croatia (authorised, recruitment pending), Germany (authorised, recruitment pending), Belgium (authorised, recruitment pending), Slovakia (authorised, recruitment pending), Czechia (authorised, recruitment pending), Italy (ongoing, recruiting).
Therapeutic area(s): Diseases [C] - Digestive System Diseases [C06]
Gender: Female, Male. Age: 18-64 years, 65+ years. Enrolment: 54.
Start date (EU): 2026-05-27. Decision date: 2025-10-20. Results received: No. Last updated: 2026-07-20.
Decision dates by country: BE: 2025-10-21, IT: 2025-10-23, BG: 2025-10-23, DE: 2025-10-24, SK: 2025-10-20, PL: 2025-10-26, HR: 2025-10-24, CZ: 2025-10-22

Condition(s): Crohn’s Disease, Ulcerative Colitis
Product: MT-501, Placebo for MT-501, film coated tablets, MT-201, MT-501

Primary endpoint: Proportion of participants reporting treatment-emergent adverse events (TEAEs), serious adverse events (SAEs), adverse events (AEs) leading to discontinuation, and markedly abnormal laboratory values, Prospective Observer-Blinded Endpoint ISAs: CD: Proportion of participants with endoscopic response at end of Induction Phase UC: Proportion of participants with endoscopic improvement at end of Induction Phase, Randomized Placebo-Controlled ISAs: Proportion of participants with clinical remission at end of Induction Phase
Endpoint(s): Proportion of participants with clinical remission at end of Induction Phase, CD: Proportion of participants with endoscopic response at end of Induction Phase UC: Proportion of participants with endoscopic improvement at end of Induction Phase, Proportion of participants with Patient-Reported Outcome-2 (PRO-2) remission at end of Induction Phase, Proportion of participants with clinical response at end of Induction Phase, CD: Proportion of participants with endoscopic and clinical response at end of Induction Phase, UC: Proportion of participants with histologic response at end of Induction Phase, UC: Proportion of participants with histologic remission at end of Induction Phase, UC: Proportion of participants with histologic-endoscopic mucosal improvement at end of Induction Phase, CD: Change in SES-CD from Day 1 to end of Induction Phase UC: Change in MES from Day 1 to end of Induction Phase, CD: Change in Global Histologic Activity Score (GHAS) and RHI from Day 1 to end of Induction Phase UC: Change in Geboes score, RHI, and Nancy Histological Index (NHI) from Day 1 to end of Induction Phase Descriptive summaries of PK of investigational drug, Descriptive summaries of PK of investigational drug

Source: https://euclinicaltrials.eu/ctis-public/view/2025-522001-38-00